EU clinical trial 2024-517502-28-01: Subcutaneous vedolizumab drug de-escalation using therapeutic drug monitoring in inflammatory bowel disease: a randomized controlled pilot study
Protocol code: NL80854.018.22
Sponsor: Amsterdam UMC Stichting (Hospital/Clinic/Other health care facility). Phase: Therapeutic use (Phase IV). Countries: Netherlands (authorised, recruiting).
Therapeutic area(s): Diseases [C] - Digestive System Diseases [C06]
Gender: Female, Male. Age: 18-64 years, 65+ years. Enrolment: 40.
Status: Authorised, recruiting. Start date (EU): 2025-01-14. Decision date: 2025-01-14. Results received: No. Last updated: 2025-01-14.

Condition(s): Inflammatory bowel disease
Product: Entyvio 108 mg solution for injection in pre-filled syringe

Primary endpoint: cost-effectiveness of therapeutic drug monitoring based drug de-escalation

Source: https://euclinicaltrials.eu/ctis-public/view/2024-517502-28-01